EU clinical trial 2025-524783-38-00: Spironolactone and SGLT2 inhibitor to Address Fontan circulatory failure and Enhance Resilience: The SAFER-Fontan trial
Sponsor: UZ Leuven (Hospital/Clinic/Other health care facility). Phase: Therapeutic confirmatory (Phase III). Countries: Belgium (authorised, recruitment pending).
Therapeutic area(s): Diseases [C] - Cardiovascular Diseases [C14]
Gender: Female, Male. Age: 18-64 years. Enrolment: 30.
Status: Authorised, recruitment pending. Decision date: 2026-08-06. Results received: No. Last updated: 2026-08-06.

Condition(s): Fontan circulation
Product: Spironolactone EG 25 mg tabletten, Placebo 500mg Fagron tablets, Forxiga 10 mg film-coated tablets

Primary endpoint: The primary efficacy assessment of the SAFER-Fontan trial is structured hierarchically to evaluate treatment effects on the principal hemodynamic domains of the Fontan circulation, while maintaining control of the overall type I error rate. 1. Primary Endpoint: PVP at rest and peak exercise, reflecting systemic venous congestion. 2. Key Secondary Endpoint: PCWP at rest and peak exercise, reflecting ventricular filling pressures.
Endpoint(s): Clinical and functional outcomes a. NYHA functional class. b. 6 minute walk distance (6MWD). c. CPET outcomes: peak oxygen uptake (VO2), metabolic equivalents (METs), heart rate and blood pressure response, oxygen saturation during exercise, VO2 at anaerobic threshold, ventilatory efficiency (VE/VCO2 slope), arterio-venous oxygen difference. d. Composite clinical worsening events. e. Patient-reported outcomes: quality of life assessed by KCCQ-12 and ACHD-PRO., Congestion outcomes a. Loop diuretic dose (furosemide-equivalent). b. Fontan Outpatient Congestion Score (FOCS), a score developed for this trial. c. Venous Excess Ultrasound (VExUS) grade., Ventricular compliance endpoints a. PVP- and PCWP-derived end-diastolic pressure-volume relationship (EDPVR): operating stiffness (dP/dV), stiffness constant β, end-diastolic volume at 15 mmHg (V15), and volume-axis intercept V0. b. Shear wave elastography (SWE)., Ventricular active relaxation endpoints a. Isovolumic relaxation time (IVRT). b. τ-Doppler (PCWP- and IVRT-based estimation of relaxation constant τ)., Echocardiography endpoints a. Pulmonary vein flow: S/D ratio, A-wave reversal duration, pulmonary venous A-wave reversal duration minus mitral inflow A-wave duration. b. Atrioventricular valve inflow: E, E deceleration time, E/A, S/D ratio. c. Ventricular inflow propagation velocity (Vp). d. Tissue Doppler velocities, including E/e’. e. Ventricular diastolic strain rate and dyssynchrony. f. Atrial function and strain., Fibrosis endpoints a. CMR tissue characterization, including native T1, ECV, and LGE. b. Standardized uptake value (SUVmean/SUVmax) of fibroblast activation within myocardium and liver parenchyma on FAPI-PET (only in subset of patients with myocardial fibrosis on pre-trial CMR)., Vascular and circulation endpoints a. Cardiac output (CO). b. Systemic vascular resistance (SVR). c. Total arterial compliance (TAC). d. Effective arterial elastance (Ea). e. Ventriculo-arterial coupling (Ea/Ees ratio). f. Mean systemic filling pressure (MSFP). g. Venous compliance and capacitance. h. Total plasma volume (TPV), total blood volume (TBV), stressed blood volume (SBV), and unstressed blood volume (UBV)., Circulating biomarkers a. RAAS activation markers: renin, angiotensin II, and aldosterone. b. Collagen turnover markers: PICP, PIIINP, PINP, CITP, and CITP/MMP-1 ratio. c. Other fibrotic and inflammatory mediators: galectin-3, soluble ST2 (sST2), and GDF-15. d. Congestion biomarkers: NT-proBNP and CA125., Extracardiac endpoints a. Hepatic function, assessed by MELD-XI score and liver elastography. b. Renal function, assessed by urinary albumin–creatinine ratio (UACR) and estimated glomerular filtration rate (eGFR)., Safety endpoints a. Serum potassium. b. Serum creatinine and cystatin C. c. Incidence, severity and causality of adverse and serious adverse events (AEs/SAEs) during study drug exposure.

Source: https://euclinicaltrials.eu/ctis-public/view/2025-524783-38-00